EU clinical trial 2024-516342-19-00: NOVEL TREATMENT OF DIABETIC FOOT ULCER BY AUTOLOGOUS STROMAL VASCULAR FRACTION OF ADIPOSE TISSUE: PHASE II OPEN-ENDED, MULTI-CENTRE STUDY (REGENDER)
Sponsor: Centre Hospitalier Regional De Marseille (Hospital/Clinic/Other health care facility). Phase: Therapeutic exploratory (Phase II). Countries: France (ongoing, recruiting).
Therapeutic area(s): Diseases [C] - Immune System Diseases [C20]; Diseases [C] - Skin and Connective Tissue Diseases [C17]
Gender: Female, Male. Age: 18-64 years, 65+ years. Enrolment: 45.
Status: Ongoing, recruiting. Start date (EU): 2024-09-13. Decision date: 2024-09-13. Results received: No. Last updated: 2024-09-13.

Condition(s): Diabetic Foot ulcERs
Product: SVF

Primary endpoint: percentage (%) of wounds completely healed by week 20 (S20) post-injection

Source: https://euclinicaltrials.eu/ctis-public/view/2024-516342-19-00